EU clinical trial 2023-508194-89-00: A Phase II, Open-Label, Multicenter, Platform Study Evaluating the Efficacy and Safety of Biomarker-Driven Therapies in Patients with Persistent or Recurrent Rare Epithelial Ovarian Tumors
Protocol code: WO42178
Sponsor: F. Hoffmann-La Roche AG (Pharmaceutical company). Phase: Therapeutic exploratory (Phase II). Countries: Spain (ongoing, recruitment ended), Czechia (ended), Germany (ongoing, recruitment ended), France (ongoing, recruitment ended), Italy (ended).
Therapeutic area(s): Diseases [C] - Neoplasms [C04]
Gender: Female. Age: 18-64 years, 65+ years. Enrolment: 57.
Start date (EU): 2021-08-30. Decision date: 2024-02-08. Results received: No. Last updated: 2026-01-06.
Decision dates by country: IT: 2024-02-08, CZ: 2024-02-08, DE: 2024-02-09, ES: 2024-02-12, FR: 2024-02-13

Condition(s): Persistent or Recurrent Rare Epithelial Ovarian Tumors
Product: Avastin 25 mg/ml concentrate for solution for infusion., Lynparza 150 mg film-coated tablets, Cotellic 20 mg film-coated tablets, Ipatasertib, Cotellic, Cotellic, INAVOLISIB, Sindaxel 6 mg/ml concentrat pentru soluţie perfuzabilă, Verzenios 50 mg film-coated tablets, Cotellic, Lynparza 100 mg film-coated tablets, Kadcyla 160 mg powder for concentrate for solution for infusion., LETRO-cell® 2,5 mg Filmtabletten, INAVOLISIB, Verzenios 100 mg film-coated tablets, INAVOLISIB, Lynparza 150 mg film-coated tablets, RO7197597, Verzenios 150 mg film-coated tablets, Paclitaxel 6 mg/ml Concentrate for Solution for Infusion, Lynparza 100 mg film-coated tablets, Tecentriq 1,200 mg concentrate for solution for infusion, IBRANCE 125 mg film-coated tablets, INAVOLISIB, IBRANCE 75 mg film-coated tablets, IBRANCE 100 mg film-coated tablets, Paclitaxel Actavis 6 mg/ml koncentrat till infusionsvätska, lösning, PACLITAXEL AHCL 6 mg/ml, solution à diluer pour perfusion, Endoxan 50 mg dengtos tabletės, Ipatasertib

Primary endpoint: Confirmed ORR as determined by the investigator according to RECIST v1.1
Endpoint(s): 1. DOR as determined by the investigator and IRC according to RECIST v1.1, 2. DCR as determined by the investigator and IRC according to RECIST v1.1, 3. PFS as determined by the investigator and IRC according to RECIST v1.1, 4. Overall survival, 5. Confirmed ORR, as determined by the IRC according to RECIST v1.1, 6. Six (6)-month PFS rate as determined by the investigator, 7. Incidence and severity of adverse events, with severity determined according to National Cancer Institute Common Terminology Criteria for Adverse Events version 5.0 (NCI CTCAE v5.0)

Source: https://euclinicaltrials.eu/ctis-public/view/2023-508194-89-00